EU clinical trial 2024-518495-31-00: 68Ga/177Lu-PSMA theranostics in recurrent grade 3 and grade 4 glioma
Protocol code: Glioma Theranostics
Sponsor: Norwegian University Of Science And Technolology (Educational Institution). Phase: Therapeutic exploratory (Phase II). Countries: Norway (ended).
Therapeutic area(s): Diseases [C] - Nervous System Diseases [C10]; Diseases [C] - Neoplasms [C04]
Gender: Female, Male. Age: 18-64 years, 65+ years. Enrolment: 10.
Status: Ended. End date (EU): 2026-05-30. Decision date: 2024-10-14. Results received: No. Last updated: 2025-02-11.

Condition(s): Recurrent grade 3 and grade 4 glioma
Product: 177Lu PSMA I&T solution for injection

Primary endpoint: Evaluation of safety and tolerability: o Type, frequency and severity of adverse events assessed with the Common Terminology Criteria for Adverse Events (CTCAE) version 5.0 (Attachment 1) and change in score in the modified RAI-6 questionnaire (Attachment 2)., Evaluation of efficacy of 177Lu- PSMA: Progression free survival (6 months) and overall survival (1 year) determined from date of commencement of 177Lu-PSMA therapy
Endpoint(s): Evaluate radiation dose to tumor and critical organs: Calculation of absorbed doses to the tumor and kidneys, parotid glands, sublingual glands, submandibular glands, lacrimal glands, liver, spleen and red marrow for each therapy cycle as well as accumulated doses for all therapy cycles., Evaluate efficacy and side effects of treatment on the following from baseline to end of each treatment cycle and to the follow up examinations: o Tumor responses as assessed by contrast enhanced MRI according to response assessment in neuro oncology (RANO) criteria and volume measurements. o Neurologic exam (nano score) o Health-related quality of life EQ-5D scores o Karnofsky performance status, Evaluate diagnostic and theranostic properties of 68Ga-PSMA

Source: https://euclinicaltrials.eu/ctis-public/view/2024-518495-31-00